EU clinical trial 2024-514824-18-00: Fixed-duration therapy with ibrutinib and obinutuzumab (GA-101) in treatment-naïve patients with CLL
Sponsor: Ospedale San Raffaele S.r.l. (Hospital/Clinic/Other health care facility). Phase: Therapeutic exploratory (Phase II). Countries: Italy (ongoing, recruiting).
Therapeutic area(s): Diseases [C] - Neoplasms [C04]
Gender: Female, Male. Age: 18-64 years, 65+ years. Enrolment: 53.
Status: Ongoing, recruiting. Start date (EU): 2021-09-16. Decision date: 2024-08-05. Results received: No. Last updated: 2024-08-05.

Condition(s): chronic lymphocytic leukemia/small lymphocytic lymphoma
Product: OBINUTUZUMAB, IBRUTINIB

Primary endpoint: Percentage of patients with MRD <10-4 in BM at +30 follow-up days after completion of therapy

Source: https://euclinicaltrials.eu/ctis-public/view/2024-514824-18-00